EU clinical trial 2024-513210-36-00: A Phase 3 Randomized, Double-Blind, Placebo-Controlled Study to Assess the Efficacy and Safety of Barzolvolimab in Patients with Chronic Spontaneous Urticaria Who Remain Symptomatic Despite H1 Antihistamine Treatment (EMBARQ – CSU2)
Protocol code: CDX0159-13
Sponsor: Celldex Therapeutics Inc. (Pharmaceutical company). Phase: Therapeutic confirmatory (Phase III). Countries: Bulgaria (ongoing, recruitment ended), Spain (ongoing, recruitment ended), Hungary (ongoing, recruitment ended), Slovakia (ongoing, recruitment ended), Italy (ongoing, recruitment ended), Netherlands (ongoing, recruitment ended), Croatia (ongoing, recruitment ended), Poland (ongoing, recruitment ended), Germany (ongoing, recruitment ended), Lithuania (ongoing, recruitment ended).
Therapeutic area(s): Diseases [C] - Skin and Connective Tissue Diseases [C17]
Gender: Female, Male. Age: 18-64 years, 65+ years. Enrolment: 528.
Status: Ongoing, recruitment ended. Start date (EU): 2025-04-04. Decision date: 2024-11-20. Results received: No. Last updated: 2026-06-03.
Decision dates by country: HU: 2024-11-25, HR: 2024-12-02, BG: 2024-11-22, SK: 2024-11-26, IT: 2024-11-27, LT: 2024-11-28, NL: 2024-11-27, ES: 2024-11-20, PL: 2024-12-02, DE: 2024-11-28

Condition(s): Chronic Spontaneous Urticaria
Product: FASTJEKT 300 Mikrogramm, Injektionslösung im Fertigpen, Placebo prefilled syringes will be identical to the prefilled syringes containing barzolvolimab but will contain only the inactive ingredients (barzolvolimab vehicle containing 0 mg/mL barzolvolimab)., BARZOLVOLIMAB

Primary endpoint: Mean change from baseline in UAS7 at Week 12
Endpoint(s): 1. Mean change from baseline in ISS7 and HSS7 at Week 12, 2. Proportion of participants with UAS7 = 0 at Week 12, 3. Proportion of participants with UAS7 ≤ 6 at Week 12, 4. Proportion of participants with AAS7 = 0 at Week 12 in participants who have AAS7 > 0 at baseline, 5. Mean change from baseline in UAS7 in participants refractory to omalizumab treatment at Week 12, 6. Proportion of participants with UAS7 = 0 in participants refractory to omalizumab treatment at Week 12

Source: https://euclinicaltrials.eu/ctis-public/view/2024-513210-36-00